EU clinical trial 2023-505079-65-00: A Phase 1, Dose Finding Study of CC-92328 in Subjects with Relapsed and/or Refractory Multiple Myeloma.
Protocol code: CC-92328-MM-001
Sponsor: Celgene Corp. (Pharmaceutical company). Phase: Human Pharmacology (Phase I)- First administration to humans. Countries: Spain (ended).
Therapeutic area(s): Diseases [C] - Neoplasms [C04]
Gender: Female, Male. Age: 18-64 years, 65+ years. Enrolment: 2.
Status: Ended. Start date (EU): 2022-04-01. End date (EU): 2024-06-18. End date: 2024-06-19. Decision date: 2023-07-10. Results received: No. Last updated: 2024-07-02.

Condition(s): Multiple myeloma

Source: https://euclinicaltrials.eu/ctis-public/view/2023-505079-65-00